EU clinical trial 2024-512479-11-00: A Long-term Follow-up Study of Subjects With Malignancies Treated With CRISPR CAR Cellular Therapies
Protocol code: CRSP-ONC-LTF
Sponsor: CRISPR Therapeutics AG (Pharmaceutical company). Phase: Phase I and Phase II (Integrated)- Other. Countries: Germany (ongoing, recruiting).
Therapeutic area(s): Diseases [C] - Neoplasms [C04]; Diseases [C] - Hemic and Lymphatic Diseases [C15]
Gender: Female, Male. Age: 18-64 years, 65+ years. Enrolment: 1.
Status: Ongoing, recruiting. Start date (EU): 2024-07-26. Decision date: 2024-05-31. Results received: No. Last updated: 2025-10-17.

Condition(s): Solid Malignancy, Hematologic Malignancy

Primary endpoint: Incidence of adverse events, including serious adverse events related to CRISPR CAR cellular therapy and adverse events of special interest
Endpoint(s): Overall survival, Duration of remission/response

Source: https://euclinicaltrials.eu/ctis-public/view/2024-512479-11-00